EU clinical trial 2024-513171-41-00: A Phase 3, Randomized, Double-Blind, Efficacy, and Safety Study of Ruxolitinib Cream in Children (6 to < 12 Years Old) With Nonsegmental Vitiligo
Protocol code: INCB 18424-309
Sponsor: Incyte Corp. (Pharmaceutical company). Phase: Therapeutic confirmatory (Phase III). Countries: Denmark (ongoing, recruiting), Hungary (ongoing, recruiting), Germany (ongoing, recruiting), Austria (ongoing, recruiting), Bulgaria (ongoing, recruiting), Portugal (ongoing, recruiting), Netherlands (ongoing, recruiting), Spain (ongoing, recruiting), Italy (ongoing, recruiting), France (ongoing, recruiting), Poland (ongoing, recruiting), Belgium (ongoing, recruiting).
Therapeutic area(s): Diseases [C] - Skin and Connective Tissue Diseases [C17]
Gender: Female, Male. Age: 0-17 years. Enrolment: 202.
Status: Ongoing, recruiting. Start date (EU): 2025-09-11. Decision date: 2025-08-20. Results received: No. Last updated: 2026-08-05.
Decision dates by country: DK: 2025-08-21, PT: 2025-08-21, AT: 2025-08-22, DE: 2025-08-22, BG: 2025-08-21, FR: 2025-08-20, HU: 2025-08-25, NL: 2025-09-11, ES: 2025-08-22, BE: 2025-08-20, IT: 2025-08-21, PL: 2025-08-22

Condition(s): Vitiligo
Product: Ruxolitinib (INCB018424) cream, Vehicle (placebo) cream, Ruxolitinib (INCB018424) cream

Primary endpoint: Proportion of participants achieving F-VASI75 at Week 24
Endpoint(s): Proportion of participants achieving F-VASI50 at Week 24, Proportion of participants achieving F-VASI90 at Week 24, Proportion of participants achieving T-VASI50 at Week 24, Percentage change from baseline in F-BSA at Week 24, AEs, assessed by changes in vital signs, clinical evaluations, height, weight, and laboratory data, Proportion of participants achieving a VNS score of 4 (a lot less noticeable) or 5 (no longer noticeable) at Weeks 24 and 52, Proportion of participants in each category for the color-matching question at Weeks 24 and 52, Proportion of participants who report F-PaGIC-V of very much improved or much improved at Weeks 24 and 52, Proportion of participants who report T-PaGIC-V of very much improved or much improved at Weeks 24 and 52, Change from baseline in VIT-PIQ at Weeks 24 and 52, Change from baseline in CDLQI at Weeks 24 and 52, Change from baseline in PGIB-V at Weeks 24 and 52, Mean satisfaction score at Weeks 24 and 52, Preapplication plasma concentrations of ruxolitinib at Weeks 4, 24, 40, and 52

Source: https://euclinicaltrials.eu/ctis-public/view/2024-513171-41-00